EU clinical trial 2024-513753-75-00: Bioequivalence of Amoxicillin and Clavulanic Acid 250 mg/62.5 mg/5 mL Powder for Oral Suspension versus Augmentin® Forte 250 mg/62.5 mg/5 mL Powder for Oral Suspension in Healthy Participants Under Fed Conditions
Protocol code: BLCL-AMC-03
Sponsor: Bial Portela & Ca S.A. (Pharmaceutical company). Phase: Human Pharmacology (Phase I)- Bioequivalence Study. Countries: Portugal (ended).
Therapeutic area(s): Not possible to specify
Gender: Female, Male. Age: 18-64 years. Enrolment: 32.
Status: Ended. Start date (EU): 2024-08-12. End date (EU): 2024-09-17. Decision date: 2024-07-11. Results received: No. Last updated: 2024-09-17.
Decision dates by country: PT: 2024-09-17

Condition(s): No medical condition.

Source: https://euclinicaltrials.eu/ctis-public/view/2024-513753-75-00